EU clinical trial 2023-510020-68-00: A first-time-in human (FTIH), Phase I/II, randomized, multi-centric, single-blind, controlled dose-escalation study to evaluate the reactogenicity, safety, immunogenicity and efficacy of GSK Biologicals’ HBV viral vector vaccines given in a prime-boost schedule with sequential or co-administration of adjuvanted proteins therapeutic vaccine (GSK3528869A) in chronic Hepatitis B patients (18-65 years old) well controlled under nucleo(s)tide analogue (NA) therapy.
Protocol code: 204852
Sponsor: GlaxoSmithKline Biologicals (Pharmaceutical company). Phase: Phase I and Phase II (Integrated)- First administration to humans. Countries: Belgium (ended), Germany (ended), Spain (ended).
Therapeutic area(s): Diseases [C] - Virus Diseases [C02]
Gender: Female, Male. Age: 18-64 years. Enrolment: 58.
Status: Ended. Start date (EU): 2019-03-18. End date (EU): 2024-10-10. End date: 2024-10-11. Decision date: 2024-03-26. Results received: Yes. Last updated: 2024-09-11.
Decision dates by country: ES: 2024-04-02, BE: 2024-04-11, DE: 2024-03-26

Condition(s): Hepatitis B, Chronic
Product: Buffer S9b Solution for suspension for injection

Primary endpoint: "• Occurrence of AEs from vaccination up to Day 337: - Occurrence of each solicited local and general symptoms within 7 days after each vaccination (from day of vaccination to six days after vaccination). - Occurrence of unsolicited AEs within 30 days after each vaccination (from day of vaccination to 29 days after vaccination). - Occurrence of hematological, biochemical or urinalysis laboratory abnormalities within 30 days after each vaccination . ", "- Occurrence of SAEs up to six months after the last dose (Day 337, Visit 22). - Occurrence of pIMDs up to six months after the last dose (Day 337, Visit 22). - Occurrence of liver-disease related AEs up to six months after the last dose (Day 337, Visit 22). - Occurrence of hematological AESIs up to six months after the last dose (Day 337, Visit 22). - Occurrence of medically attended events (MAEs) up to six months after the last dose (Day 337, Visit 22). "
Endpoint(s): "Immunogenicity Immunogenicity with respect to HBV components of the viral vectored vaccines and adjuvanted proteins vaccines, at predefined time points (see Table 4 and Table 5). • Anti-HBc antibodies: seropositivity and concentration. • Anti-HBs antibodies: seroconversion and concentration; anti-HBs ≥10 mIU/ml and ≥100 mIU/ml. • Frequency of HBc- and HBs- specific CD4+ T-cells and CD8+ T-cells; CD4+ T-cells responder, CD8+ T-cells responder.", "Efficacy • qHBsAg: number of patients with ≥ 0.5 log decrease, ≥ 1-log decrease, HBsAg loss and log-changes since pre-vaccination. • Number of patients with HBsAg loss and anti-HBs seroconversion. • Mean qHBsAg in each group. ", "Safety • Occurrence of AEs from vaccination up to Day 841: - Occurrence of any SAEs throughout the study period, - Occurrence of SAEs causally related to an investigational vaccine throughout the study period, - Occurrence of MAEs throughout the study period, - ", "- Occurrence of pIMDs throughout the study period, - Occurrence of liver disease-related AEs throughout the study period, - Occurrence of spontaneous local or general bleeding with thrombocytopenia (< 50,000 platelets/mm3), - Occurrence of anemia with Hb < 9.5 g/dl, - Occurrence of AEs and SAEs leading to study withdrawal. • Pregnancy and pregnancy outcome throughout the study period. "

Source: https://euclinicaltrials.eu/ctis-public/view/2023-510020-68-00